EU clinical trial 2022-501979-10-00: European Randomised Clinical Trial on mPOX Infection (EPOXI)
Sponsor: University Medical Center Utrecht (Hospital/Clinic/Other health care facility). Phase: Therapeutic use (Phase IV). Countries: Netherlands (ended), France (ended), Portugal (ended), Germany (ended), Belgium (ended), Spain (ended), Norway (ended), Italy (ended).
Therapeutic area(s): Diseases [C] - Virus Diseases [C02]
Gender: Female, Male. Age: 18-64 years, 65+ years. Enrolment: 335.
Status: Ended. Start date (EU): 2024-08-08. End date (EU): 2025-07-14. Decision date: 2022-12-19. Results received: Yes. Last updated: 2025-06-26.
Decision dates by country: IT: 2024-09-18, NL: 2022-12-19, PT: 2022-12-22, DE: 2022-12-20, FR: 2022-12-19, NO: 2023-05-02, BE: 2022-12-20, ES: 2023-01-16

Condition(s): Monkeypox
Product: Placebo capsules are identical to active tpoxx capsules, and will be relabelled identical to the study drug. placebo capsules will have the same composition, except for the active substance. (microcrystalline cellulose, lactose monohydrate, croscarmellose sodium, colloidal silicon dioxide, hypromellose, sodium lauryl sulfate, magnesium stearate and purified water, in an opaque orange/black hard gelatin capsule shell size 0.)., Tecovirimat SIGA 200 mg hard capsules

Primary endpoint: Time (days) to complete lesion resolution, counted from start of therapy, assessed at day 28 after randomisation and defined as the first day on which all lesions are completely healed with a new fresh layer of skin. For skin lesions, typically this means the lesion has scabbed, desquamated and new layer of skin formed (if a scar present, this is still defined as complete lesion resolution). For mucosal lesions, the phase of scabbing and desquamation is absent, and healing with new layer of skin
Endpoint(s): Time (days) to active lesion resolution, defined as the first day on which all skin lesions are scabbed or desquamated (and mucosal lesions healed), with follow-up up to 28 days after randomisation., Status of the lesions on day 7, 14, 21 and 28 according to an ordinal scale. The ordinal scale is a) all lesions completely resolved (all scabs dropped off and intact skin remains underneath, and all mucosal lesions healed), b) active lesions resolved (all skin lesions scabbed or desquamated, but not fully resolved), c) active lesions persist but no new lesions in last 24 hours, d) new lesion(s) in last 24 hours., Time to resolution of symptoms. Symptoms are assessed by self-assessment and include fatigue, malaise, nausea, vomiting, abdominal pain, anorexia, cough, dysphagia, odynophagia, fever, headache, oral pain, pain with urination, rectal/anal pain. Signs will be evaluated at study visits only, including lymphadenopathy and proctitis, and are not included in the evaluation of symptoms., Occurrence of a negative monkeypox PCR of skin or mucosa swab, assessed for the most active skin or mucosa lesion at days 7, 14 and 28., Persistence of scars and skin discoloration, assessed on day 90 (and day 60 if the visit is live)., Change from baseline in quality of life on day 7, 14, 28 and 90 by the Dermatology Quality of Life Index (DQLI), All-cause mortality within 28 days and within 90 days, applicable to all patients, Time to complication, all-cause admission to hospital or all-cause death, within 28 days and 90 days, applicable to outpatients only., Frequency of AEs, SAEs and SUSARs for the specific therapeutic, within the first 28 days, but also assessed during the total follow-up (up to day 90), In a subset of patients with pain at lesion site (or proctitis) at baseline: Resolution of pain, by measuring (a) time to resolution of pain assessed by the Numeric Rating Scale (NRS) for pain (Karcioglu 2018), (b) time to cessation of the use of analgesic medication, defined as time to consistently reporting no use of analgesia for monkeypox-related lesions, up to 90 days after randomisation. (c) anal pain on days 7, 14, 28, 60 and 90 assessed by the Health Related Symptom Index

Source: https://euclinicaltrials.eu/ctis-public/view/2022-501979-10-00